EU clinical trial 2024-515902-15-00: A Phase II, single-arm trial of Atezolizumab/Platinum/Etoposide for the treatment of advanced large-cell neuroendocrine cancer of the lung (LCNEC-ALPINE)
Protocol code: TUD-ALPINE-077
Sponsor: Technische Universitaet Dresden (Educational Institution). Phase: Therapeutic exploratory (Phase II). Countries: Germany (ongoing, recruitment ended).
Therapeutic area(s): Diseases [C] - Neoplasms [C04]
Gender: Female, Male. Age: 18-64 years, 65+ years. Enrolment: 67.
Status: Ongoing, recruitment ended. Start date (EU): 2022-01-18. Decision date: 2024-10-24. Results received: No. Last updated: 2026-04-09.

Condition(s): Male and female adult patients with locally advanced or metastatic large-cell neuroendocrine carcinoma of the lung not eligible for curative treatment
Product: Tecentriq 1 200 mg concentrate for solution for infusion, CARBOPLATIN, CISPLATIN, ETOPOSIDE

Primary endpoint: Overall Survival (OS, time to event endpoint, measured from cycle 1 day 1 (C1D1) to death from any cause)
Endpoint(s): Objective response rate (ORR) defined as partial remission (PR) or complete remission (CR) according to RECIST v1.1, Immune ORR (iORR) defined as immune PR (iPR) or immune CR (iCR) according to iRECIST, Disease control rate (DCR) defined as combination of CR, PR and stable disease (SD) according to RECIST v1.1, Progression free survival (PFS) defined as time from C1D1 to progression according to RECIST v1.1, or to start of any other anticancer treatment, or death from any cause whichever occurs first, Immune PFS (iPFS) defined as time from C1D1 to progression according to iRECIST or death from any cause whichever occurs first, Duration of response (DoR) defined as time from first documented PR or CR according to RECIST v1.1 to time of disease progression according to RECIST v1.1 or death from any cause whichever occurs first, PFS/ iPFS (according to RECIST v1.1 and iRECIST) rate at 1 year, OS rate at 1 year, PFS, OS, DoR and ORR in central pathology confirmed cases of LCNEC, Incidence, nature, severity of adverse events (grading according to NCI CTCAE (v5.0)

Source: https://euclinicaltrials.eu/ctis-public/view/2024-515902-15-00